EU clinical trial 2026-526556-31-00: Randomized, open-label, multiple dose, two-period, two-treatment, cross-over pharmacodynamic study in healthy male and female participants under fasting conditions.
Protocol code: 1090/26
Sponsor: Adamed Pharma S.A. (Pharmaceutical company). Phase: Human Pharmacology (Phase I)- Other. Countries: Czechia (ongoing, recruitment ended).
Therapeutic area(s): Diseases [C] - Cardiovascular Diseases [C14]
Gender: Female, Male. Age: 18-64 years. Enrolment: 42.
Status: Ongoing, recruitment ended. Start date (EU): 2026-06-03. Decision date: 2026-06-02. Results received: No. Last updated: 2026-06-09.

Condition(s): Pharmacodynamic study under fasting condition.

Source: https://euclinicaltrials.eu/ctis-public/view/2026-526556-31-00